EU clinical trial 2023-508391-11-00: Investigating the safety, feasibility, and optimal dose of fluorescently labeled Adalimumab-680LT for visualizing drug targeting in Inflammatory Bowel Diseases.
Protocol code: 18146
Sponsor: Universitair Medisch Centrum Groningen (Hospital/Clinic/Other health care facility). Phase: Phase I and Phase II (Integrated)- First administration to humans. Countries: Netherlands (ended).
Therapeutic area(s): Diseases [C] - Immune System Diseases [C20]; Diseases [C] - Digestive System Diseases [C06]
Gender: Female, Male. Age: 18-64 years, 65+ years. Enrolment: 18.
Status: Ended. Start date (EU): 2024-03-21. End date (EU): 2026-01-06. Decision date: 2024-01-10. Results received: No. Last updated: 2024-02-21.

Condition(s): Inflammatory Bowel Disease (IBD)
Product: Humira 40 mg solution for injection in pre-filled syringe

Primary endpoint: Monitoring of the vital signs before and after tracer administration and evaluating possible (severe) adverse events (SAE & AEs). Visual evaluation during FME (visible signal yes/no), TBR and CNR calculations, mean fluorescence intensities (MFIs) of biopsies, MDSFR/SFF measurements and fluorescence/ light sheet microscopy.
Endpoint(s): Comparison of in vivo fluorescence images, MFIs of biopsies, the MDSFR/SFF measurements, fluorescence microscopy results, and tracer concentrations inside biopsies before and after at least 14 weeks of adalimumab treatment., Quantification of MDSFR/SFF measurements in inflamed tissue compared to measurements in non-inflamed tissue. Positive correlation between MDSFR/SFF measurements and dose/inflammation severity?, Histologically ascertained tissue types (qualitative): • Normal (non-inflamed) ileal, colon and rectal tissue. • Inflamed ileum, colon and rectum tissue. • Random ‘’high-fluorescent’’ tissue • Random ‘’Non-fluorescent’’ tissue, Fluorescence (confocal) microscopy with additional use of immune panels and spatial transcriptomics analysis (before and after at least 14 weeks of adalimumab treatment). Measurements of the adalimumab-680LT concentration by light-sheet microscopy after tissue clearing, insights in adalimumab-target cells and presence of immune cells inside the biopsies and blood samples by flow cytometry and assessment of tracer stability by Western Blot.

Source: https://euclinicaltrials.eu/ctis-public/view/2023-508391-11-00